EU clinical trial 2024-512526-28-00: Multicentre, open-label, randomized, controlled, parallel arms clinical trial of induction chemotherapy followed by chemoradiotherapy versus chemoradiotherapy alone as neoadjuvant treatment for locally recurrent rectal cancer (PelvEx II)
Protocol code: NL73593.100.20
Sponsor: Catharina Ziekenhuis Stichting (Hospital/Clinic/Other health care facility). Phase: Therapeutic confirmatory (Phase III). Countries: Norway (ongoing, recruiting), Portugal (ongoing, recruiting), Sweden (ongoing, recruiting), Netherlands (ongoing, recruiting), Belgium (ongoing, recruiting).
Therapeutic area(s): Diseases [C] - Digestive System Diseases [C06]; Diseases [C] - Neoplasms [C04]
Gender: Female, Male. Age: 18-64 years, 65+ years. Enrolment: 364.
Status: Ongoing, recruiting. Start date (EU): 2020-10-28. Decision date: 2024-04-12. Results received: No. Last updated: 2026-02-06.
Decision dates by country: BE: 2024-04-19, PT: 2024-04-12, SE: 2024-04-12, NO: 2024-04-12, NL: 2024-04-12

Condition(s): Locally recurrent rectal cancer
Product: Xeloda 150 mg film-coated tablets, Irinotecan Hydrochloride medac 20 mg/ml, concentrate for solution for infusion., Fluorouracil Injection, 50 mg/ml, solution for injection, Teysuno 15 mg/4.35 mg/11.8 mg hard capsules, Calcium Folinate 10 mg/ml Injection, Oxaliplatin 5 mg/ml concentrate for solution for infusion

Primary endpoint: The rate of clear resection margins after surgery
Endpoint(s): Local re-recurrence free survival, Progression free survival, Distant metastasis free survival, Disease free survival, Overall survival, Pathologic response, Radiological response, Systemic therapy related toxicity (NCI-CTCAE v5.0 grade ≥3), The number of patients completing neoadjuvant treatment, Surgical characteristics, Major postoperative complications (Clavien-Dindo ≥3) up to 90-days postoperatively, Quality of life, Cost-effectiveness

Source: https://euclinicaltrials.eu/ctis-public/view/2024-512526-28-00